EU clinical trial 2023-509751-14-03: Efficacy of doravirine + dolutegravir dual therapy in the context of antiretroviral therapy switch
Protocol code: CW004
Sponsor: Chelsea And Westminster Hospital NHS Foundation Trust (Hospital/Clinic/Other health care facility). Phase: Therapeutic exploratory (Phase II). Countries: Italy (ongoing, recruitment ended).
Therapeutic area(s): Diseases [C] - Immune System Diseases [C20]
Gender: Female, Male. Age: 18-64 years, 65+ years. Enrolment: 50.
Status: Ongoing, recruitment ended. Start date (EU): 2025-02-27. Decision date: 2024-11-29. Results received: No. Last updated: 2026-05-21.

Condition(s): HIV
Product: Tivicay 50 mg film-coated tablets, Pifeltro 100 mg film-coated tablets

Primary endpoint: The primary endpoint will be a comparison of the percentage of participants in each treatment arm with undetectable plasma HIV RNA levels at week 48. Undetectable will be defined as plasma RNA levels of <50 copies/ml. Any patient with HIV RNA levels >50 copies/ml at analysis time points will have a repeat test. If the result from the repeat test is below 50 copies/ml the participant will be classified as a responder.
Endpoint(s): Absolute efficacy of study treatments: Proportion of patients treated on each arm with HIV viral load <50 copies/ml at weeks 24,72,96., Safety and tolerability: 1 Occurrence of adverse events (including laboratory results), severity of adverse events and occurrence of treatment discontinuations due to tolerability of treatments., Safety and tolerability- 2. Changes in CD4 count and CD4:CD8 ratio at screening, weeks 24, 48, 72 and 96, Safety and tolerability - 3. Occurrences and details of viral resistance in study participants, Safety and tolerability- 4. Scores from participant-recorded outcome measures at weeks 0, 24, 48, 72 and 96: • EuroQoL Questionnaire • Patient Treatment Satisfaction Questionnaire • Pittsburgh Sleep Questionnaire

Source: https://euclinicaltrials.eu/ctis-public/view/2023-509751-14-03